EU clinical trial 2024-511321-54-00: PEITHO-3 - A reduced dose of thrombolytic treatment for patients with intermediate high-risk acute pulmonary embolism: a randomized controlled trial
Protocol code: P160924
Sponsor: Assistance Publique Hopitaux De Paris (Hospital/Clinic/Other health care facility). Phase: Therapeutic confirmatory (Phase III). Countries: Netherlands (ongoing, recruitment ended), Spain (ongoing, recruitment ended), Italy (ongoing, recruitment ended), Germany (ongoing, recruitment ended), Austria (ongoing, recruitment ended), France (ongoing, recruitment ended), Slovenia (ongoing, recruitment ended), Poland (ongoing, recruitment ended).
Therapeutic area(s): Diseases [C] - Cardiovascular Diseases [C14]
Gender: Female, Male. Age: 18-64 years, 65+ years. Enrolment: 760.
Status: Ongoing, recruitment ended. Start date (EU): 2021-08-04. Decision date: 2024-06-17. Results received: No. Last updated: 2026-03-19.
Decision dates by country: NL: 2024-06-17, AT: 2024-07-30, DE: 2024-06-18, FR: 2024-06-20, ES: 2024-06-18, PL: 2024-07-10, IT: 2024-07-02, SI: 2024-06-19

Condition(s): intermediate-high-risk acute pulmonary embolism
Product: ACTILYSE 50mg placebo, ACTILYSE, poudre et solvant pour solution injectable et perfusion

Primary endpoint: The primary outcome is the composite of (1) death from any cause, or (2) hemodynamic decompensation, or (3) objectively confirmed recurrent PE at day 30.
Endpoint(s): Fatal or GUSTO severe or life-threatening bleeding within 30 days, Net clinical benefit defined as the composite of the primary efficacy outcome and GUSTO severe or life-threatening bleeding within 30 days, All-cause mortality within 30 days

Source: https://euclinicaltrials.eu/ctis-public/view/2024-511321-54-00